EU clinical trial 2024-514321-39-00: A multicenter, multinational, pharmacokinetic, safety, and efficacy study with IV NEPA (fosnetupitant/palonosetron) for the prevention of chemotherapy-induced nausea and vomiting in pediatric cancer patients undergoing highly emetogenic chemotherapy (HEC). A 2-part study with Phase 2, open-label, randomized, single-dose IV NEPA vs fosaprepitant/ondansetron in single-day HEC and repeated-dose IV NEPA in multi-day HEC (Part I, single cycle) and with Phase 3, double-blind, randomized, repeated-dose IV NEPA vs aprepitant/ondansetron in multi-day HEC (Part II, repeated cycles).
Protocol code: NEPA-22-01
Sponsor: Helsinn Healthcare S.A. (Pharmaceutical company). Phase: Phase II and Phase III (Integrated). Countries: Poland (ongoing, recruiting), Greece (ongoing, recruiting), Romania (ongoing, recruiting).
Therapeutic area(s): Diseases [C] - Pathological Conditions, Signs and Symptoms [C23]
Gender: Female, Male. Age: 0-17 years. Enrolment: 80.
Status: Ongoing, recruiting. Start date (EU): 2025-05-06. Decision date: 2025-04-24. Results received: No. Last updated: 2026-06-15.
Decision dates by country: PL: 2025-04-27, GR: 2025-04-24, RO: 2025-04-28

Condition(s): Chemotherapy-induced nausea and vomiting
Product: fosnetupitant chloride 260 mg/palonosetron 2.5 mg, Sodium Chloride Injection BP 0.9% w/v, IVEMEND 150 mg powder for solution for infusion, Ondansetrone Hikma 8 mg/4 ml Soluzione iniettabile, fosnetupitant chloride 260 mg/palonosetron 1.5 mg

Primary endpoint: Part I: Cohort 1: Netupitant exposure parameters maximum concentration (Cmax) and area under the plasma concentration-time curve from time zero to the last measurable timepoint (AUClast) and to infinity (AUCinf)., Part I: Cohort 2: Safety parameters (monitoring of AEs, physical examination, vital signs, clinical laboratory tests [haematology, serum chemistry and urinalysis], and 12-lead ECG) following repeated IV NEPA administration (Days 1, 3 and Days 1, 3, 5) to paediatric cancer patients receiving multi-day HEC treatment., Part II: Proportion of patients with CR (i.e., no emetic episodes and no rescue medication) during the delayed (>24-120 h) phase of emesis after start of chemotherapy administration in Cycle 1.
Endpoint(s): Part I: Cohort 1: Physical examination, vital signs, clinical laboratory tests (haematology, serum chemistry and urinalysis), 12-lead ECG, and AEs., Part I: Cohort I: - Other PK parameters for netupitant: tmax, (λz, t1/2, AUC0-48), AUC0-120 SD, CL/F, and Vz/F. PK parameters for netupitant metabolites M1, M2, and M3: Cmax, tmax, AUClast, AUC0-48, AUC0-120 SD, AUCinf, λz, t1/2, CL/F, and Vz/F. - PK parameters for fosnetupitant and palonosetron: Cmax, tmax, AUClast, AUC0-48, AUCinf, λz, t1/2, CL, and Vz., Part I: Cohort 1 and Cohort 2: Population PK analysis using samples of patients from both Cohorts and all Age Groups to characterise PK values for fosnetupitant, netupitant, netupitant metabolites M1, M2, and M3, and palonosetron in paediatric patients upon single and multiple IV NEPA administration., Part I: Cohort 1 and Cohort 2: PK/PD correlations between netupitant and palonosetron exposure parameters and antiemetic efficacy parameters (CR)., Part I: Cohort 1 and Cohort 2: Efficacy parameters, such as Proportion of patients with CR, Proportion of patients with no emetic episodes, Proportion of patients with no rescue medication, and Time to treatment failure, Part II: in Cycle 1 and repeated Cycles: Efficacy parameters, such as Proportion of patients with CR during the acute delayed and overall phase of emesis, Proportion of patients with no emetic episodes, Proportion of patients with no vomiting, Proportion of patients with no rescue medication, Proportion of patients with no nausea and no use of rescue medication, and Time to treatment failure, Part II: in Cycle 1 and repeated Cycles: Population PK for fosnetupitant, netupitant, netupitant metabolites, and palonosetron will be evaluated using pooled plasma concentration-time data from Study Part I and Part II., Part II: in Cycle 1 and repeated Cycles: Physical examination, vital signs, clinical laboratory tests (haematology, serum chemistry and urinalysis), 12-lead ECG, and AEs.

Source: https://euclinicaltrials.eu/ctis-public/view/2024-514321-39-00